EU clinical trial 2022-500966-82-00: NEoadjuvant chemoradiotherapy for Esophageal squamous cell carcinoma versus Definitive chemoradiotherapy with salvage Surgery as needed (The NEEDS Trial)
Sponsor: Karolinska University Hospital (Hospital/Clinic/Other health care facility). Phase: Therapeutic confirmatory (Phase III). Countries: Ireland (authorised, recruiting), Sweden (ongoing, recruiting), Norway (authorised, recruiting), France (authorised, recruiting).
Therapeutic area(s): Diseases [C] - Neoplasms [C04]
Gender: Female, Male. Age: 18-64 years, 65+ years. Enrolment: 235.
Start date (EU): 2020-03-11. Decision date: 2023-10-20. Results received: No. Last updated: 2025-05-07.
Decision dates by country: FR: 2025-05-07, IE: 2023-10-20, SE: 2023-10-23, NO: 2023-11-09

Condition(s): Resectable locally advanced squamous cell carcinoma (SCC) of the esophagus
Product: Fluorouracil Accord 50 mg/ml injektions-/infusionsvätska, lösning, Cisplatin Accord 1 mg/ml koncentrat till infusionsvätska, lösning, Carboplatin Accord 10 mg/ml koncentrat till infusionsvätska, lösning, Paclitaxel Accord 6 mg/ml koncentrat till infusionsvätska, lösning, Calcium folinate Sandoz 10 mg/ml injektions-/infusionsvätska, lösning, Oxaliplatin Accord 5 mg/ml koncentrat till infusionsvätska, lösning

Primary endpoint: Overall survival (OS) with a minimum follow-up of 3 years., Health-related quality of life (HRQOL) one year after randomization
Endpoint(s): Event free survival (EFS), defined as time to relapse, initiation of any anti-tumor therapy beyond the study treatments (salvage surgery is considered a study treatment in the dCRT arm), or death, whichever comes first., Loco-regional and distant relapse rates, including the relation of relapse location to the radiation field., Histopathological response according to Mandard, as well as other pathological data in operated patients, ypTNM including total and metastatic lymph node count, tumour free resection margins, R0., Health economy will be assessed including patient-level medical resource use and societal costs due to sick-leave and other non-medical costs. Quality-adjusted life years (QALYs) will be calculated using EQ-5D, reported at baseline and 6, 12, 24, 36 and 60 months after randomisation., Surgical complications according to the Esophagectomy Complications Consensus Group and classified according to Clavien-Dindo., Treatment-related adverse events and toxicity coded by NCI.CTCAE criteria version 5.0., Nutritional outcomes including weight development, dysphagia and appetite assessment., Gender stratified analyses of all endpoints., Exploratory analyses for putative tissue and liquid biomarkers for response to RCT and benefit from either of the two treatment strategies (optional per center)., HRQOL will be assessed at baseline, meaning after inclusion and signing of the patient consent form but before start of treatment and thereafter 6, 12, 24, 36 and 60 months after randomization

Source: https://euclinicaltrials.eu/ctis-public/view/2022-500966-82-00